EU clinical trial 2024-511331-96-00: A Phase 2 Open-Label Extension Study to Evaluate the Long-Term Safety and Efficacy of ARO-APOC3 in Adults with Dyslipidemia
Protocol code: AROAPOC3-2003
Sponsor: Arrowhead Pharmaceuticals Inc. (Pharmaceutical company). Phase: Therapeutic exploratory (Phase II). Countries: Poland (ended), Hungary (ended), Netherlands (ended).
Therapeutic area(s): Diseases [C] - Nutritional and Metabolic Diseases [C18]
Gender: Female, Male. Age: 18-64 years, 65+ years. Enrolment: 178.
Status: Ended. Start date (EU): 2024-07-04. End date (EU): 2025-12-02. End date: 2026-02-20. Decision date: 2024-07-04. Results received: No. Last updated: 2025-10-20.
Decision dates by country: HU: 2024-07-04, PL: 2024-07-23, NL: 2024-07-04

Condition(s): Mixed Dyslipidemia
Product: ARO-APOC3

Primary endpoint: Subject incidence of treatment-emergent adverse events (TEAEs)
Endpoint(s): Change and percent change from baseline over time in fasting TG (triglyceride), Change and percent change from baseline over time in apolipoprotein (Apo)C-III, Change and percent change from baseline over time in fasting non-high-density lipoprotein cholesterol (non-HDL-C), Change and percent change from baseline over time in fasting HDL-C, Change and percent change from baseline over time in fasting total apolipoprotein B (ApoB), Change and percent change from baseline over time in fasting LDL-C (low-density lipoprotein cholesterol) using ultracentrifugation

Source: https://euclinicaltrials.eu/ctis-public/view/2024-511331-96-00